EU clinical trial 2024-511663-28-00: Effect of long-term carvedilol to prevent decompensation or death in patients with asymptomatic Child-Pugh A5 to B8 cirrhosis and clinically significant portal hypertension: a multicenter, double-blind, randomized controlled trial.
Protocol code: CARVECIR
Sponsor: Centre Hospitalier Regional Universitaire De Tours (Hospital/Clinic/Other health care facility). Phase: Therapeutic use (Phase IV). Countries: France (ongoing, recruiting).
Therapeutic area(s): Diseases [C] - Pathological Conditions, Signs and Symptoms [C23]
Gender: Female, Male. Age: 18-64 years, 65+ years. Enrolment: 300.
Status: Ongoing, recruiting. Start date (EU): 2025-09-11. Decision date: 2025-02-17. Results received: No. Last updated: 2026-06-04.

Condition(s): Asymptomatic Child-Pugh A5 to B8 cirrhosis
Product: Carvedilol NORMON 6.25 mg tablets EFG., Le produit est un comprimé sécable blanc, de forme ovale, de longueur 8mm, avec une gravure F57 sur une face et une barre de sécabilité sur l’autre face. La composition est la suivante : Excipients -> Prosolv Easytab SP , (Cellulose microcristalline, Silice colloïdale, Sodium starch glycolate, Sodium stéaryl fumarate)

Primary endpoint: Primary endpoint will be the occurrence, within 36 months after inclusion, of either decompensation of cirrhosis or liver-related death.
Endpoint(s): 1. Safety of carvedilol (<=12.5 mg per day) on: (a) Systemic hemodynamics (heart rate, blood pressure), (b) Cardiac function (c) any other adverse effects and reactions within 36 months after inclusion, Effect of low dose carvedilol (<=12.5 mg per day), within 36 months after randomization, 3. To assess treatment compliance: record of unused packaging and information about compliance in a patient notebook, 4. To identify potential predictors of decompensation (see primary endpoint for definition) in the control group: - New biomarkers (from ancillary studies) using the biological samples - These results will be adjusted on potential confounding factors, including liver function tests, features of portal hypertension and ethnic origin, 5. To identify potential predictors of response to carvedilol (in the group receiving carvedilol): - Levels and variation of liver and spleen stiffness at baseline, and week 2 - Heart rate, systolic and mean blood pressure and its variation at baseline and week 2, 6. Occurrence, within 36 months after inclusion, of either decompensation of cirrhosis or liver-related death according to subgroups (a) main etiology of cirrhosis (alcohol, viral, or metabolic) (b) history of previous decompensation (c) alcohol consumption (d) features of metabolic syndrome

Source: https://euclinicaltrials.eu/ctis-public/view/2024-511663-28-00